EU clinical trial 2024-517706-29-00: Effects of N-Acetyl-L-Leucine on Ataxia-Telangiectasia (A-T): A Phase III, randomized, placebo-controlled, double-blind, crossover study
Protocol code: IB1001-303
Sponsor: Intrabio Limited (Pharmaceutical company). Phase: Therapeutic confirmatory (Phase III). Countries: Germany (ongoing, recruiting), Slovakia (ongoing, recruiting), Spain (ongoing, recruiting).
Therapeutic area(s): Diseases [C] - Congenital, Hereditary, and Neonatal Diseases and Abnormalities [C16]
Gender: Female, Male. Age: 0-17 years, 18-64 years, 65+ years. Enrolment: 70.
Status: Ongoing, recruiting. Start date (EU): 2025-05-13. Decision date: 2025-03-25. Results received: No. Last updated: 2026-07-09.
Decision dates by country: SK: 2025-04-16, ES: 2025-03-25, DE: 2025-03-25

Condition(s): Ataxia Telangiectasia
Product: granules for suspension, N-Acetyl-L-Leucine

Primary endpoint: The primary endpoint for the study is of the Scale for the Assessment and Rating of Ataxia
Endpoint(s): Spinocerebellar Ataxia Functional Index (SCAFI) is one of the four secondary endpoints., International Cooperative Rating Scale (ICARS) is one of the four secondary endpoints., Quality of Life EQ-5D-5L for patients aged ≥18; EQ-5D-Y for patients aged <18 years is one of the four secondary endpoints., Investigator’s, Caregiver’s (if applicable), and Patient’s (if able) Clinical Global Impression of Improvement (CGI-I) comparing end of period I (Visit 4) to baseline (Visit 2) is one of the four secondary endpoints.

Source: https://euclinicaltrials.eu/ctis-public/view/2024-517706-29-00